EU clinical trial 2023-506577-35-00: A Clinical Study to Evaluate the Safety and Pharmacokinetics of JNJ- 73841937 (Lazertinib), a Third Generation EGFR-TKI, as Monotherapy or in Combinations With JNJ-61186372, a Human Bispecific EGFR and cMet Antibody in Participants With Advanced Non-Small Cell Lung Cancer
Protocol code: 73841937NSC1001
Sponsor: Janssen - Cilag International (Pharmaceutical company). Phase: Human Pharmacology (Phase I)- Other. Countries: Spain (ongoing, recruitment ended), Italy (ongoing, recruitment ended), France (ongoing, recruitment ended), Germany (ongoing, recruitment ended).
Therapeutic area(s): Diseases [C] - Neoplasms [C04]
Gender: Female, Male. Age: 18-64 years, 65+ years. Enrolment: 209.
Status: Ongoing, recruitment ended. Start date (EU): 2020-09-08. Decision date: 2024-03-13. Results received: No. Last updated: 2026-03-09.
Decision dates by country: DE: 2024-03-18, FR: 2024-03-15, ES: 2024-03-18, IT: 2024-03-13

Condition(s): Advanced Non-Small Cell Lung Cancer

Source: https://euclinicaltrials.eu/ctis-public/view/2023-506577-35-00